EU clinical trial 2023-507074-40-00: ADME: A Study to Understand What the Body does to the Study Compound Called PF-07220060 When Taken by Healthy Adults.
Protocol code: C4391010
Sponsor: Pfizer Inc. (Pharmaceutical company). Phase: Human Pharmacology (Phase I)- Other. Countries: Netherlands (ended).
Therapeutic area(s): Diseases [C] - Neoplasms [C04]
Gender: Male. Age: 18-64 years. Enrolment: 12.
Status: Ended. Start date (EU): 2024-01-26. End date (EU): 2024-04-12. End date: 2024-04-13. Decision date: 2023-12-14. Results received: No. Last updated: 2024-02-27.

Condition(s): metastatic/advanced breast cancer

Source: https://euclinicaltrials.eu/ctis-public/view/2023-507074-40-00